EU clinical trial 2024-515569-32-00: Evaluation of safety and efficacy of mitapivat sulfate in adult patients with sickle cell disease
Sponsor: Julius Clinical Research B.V. (Patient organisation/association). Phase: Therapeutic exploratory (Phase II). Countries: Netherlands (ongoing, recruitment ended).
Therapeutic area(s): Diseases [C] - Hemic and Lymphatic Diseases [C15]
Gender: Female, Male. Age: 0-17 years, 18-64 years. Enrolment: 10.
Status: Ongoing, recruitment ended. Start date (EU): 2020-09-24. Decision date: 2024-08-01. Results received: No. Last updated: 2026-07-20.

Condition(s): Sickle cell disease
Product: MITAPIVAT, MITAPIVAT, MITAPIVAT

Primary endpoint: Safety of AG-348 including the type, incidence, severity and relationship of AG-348 to AE and SAE; number of medication discontinuations due to AE; physical examination findings, vital signs and 12-lead electrocardiogram (ECG) data., Efficacy of treatment of AG-348 as evaluated by changes in sickling behaviour (Point of Sickling) as quantified by the Oxygenscan (= primary main study parameter)., Efficacy of treatment of AG-348 evaluated by percentage of responders defined as: o Anti-sickling response o Hematological response
Endpoint(s): Maximum change in Hb, bilirubin, HbCO, p50 (TCS HEMOX Analyzer), 2,3-DPG and ATP levels., Maximum change in RBC deformability, dehydration and cell membrane stability, ex vivo (Osmotic gradient ektacytometry (Osmoscan)., Changes in clinical characteristics: o Health related Quality of Life (HRQoL) (EQ-5D-5L, SF-36). o Movement behaviour (accelerometer Activ8) o Dyspnea (MRC dyspnea) o Fatigue (PROMIS fatigue short form), Changes in surrogate markers of organ damage or biomarkers associated with mortality at D56 compared to baseline: o Urinary albumin to creatinine ratio o NT-proBNP o CRP o LDH/HbCO ratio o Endothelial activation: D-dimer, von Willebrand factor-antigen (VWF-Ag), soluble vascular cell adhesion molecule-1 (sVCAM-1) o Change in number of crises compared to historical rate

Source: https://euclinicaltrials.eu/ctis-public/view/2024-515569-32-00